EU clinical trial 2023-503823-24-01: A Phase 1 Study of CD19-targeted NEX-T CAR T Cells in Participants with Severe, Refractory Autoimmune Diseases (Breakfree-1)
Protocol code: CA061-1001
Sponsor: Celgene Corp. (Pharmaceutical company). Phase: Human Pharmacology (Phase I)- Other. Countries: Italy (temporarily halted), France (temporarily halted), Germany (temporarily halted), Belgium (temporarily halted), Spain (temporarily halted).
Therapeutic area(s): Diseases [C] - Immune System Diseases [C20]
Gender: Female, Male. Age: 18-64 years, 65+ years. Enrolment: 126.
Status: Temporarily halted. Start date (EU): 2024-04-15. Decision date: 2024-04-09. Results received: No. Last updated: 2026-08-03.
Decision dates by country: FR: 2024-04-11, IT: 2024-04-12, BE: 2024-04-10, ES: 2024-04-09, DE: 2024-04-15

Condition(s): Idiopathic Inflammatory Myopathy, Systemic Sclerosis, Rheumatoid Arthritis (RA), Systemic Lupus Erythematosus (SLE)

Source: https://euclinicaltrials.eu/ctis-public/view/2023-503823-24-01